EU clinical trial 2025-521686-27-01: AIDA-DEP - Accelerated Intermittent theta-burst stimulation with D-cycloserine Augmentation for DEPression - a multicenter, randomized, placebo-controlled, double-blind clinical trial
Sponsor: Region Uppsala (Hospital/Clinic/Other health care facility). Phase: Therapeutic exploratory (Phase II). Countries: Sweden (ongoing, recruiting).
Therapeutic area(s): Diseases [C] - Nervous System Diseases [C10]
Gender: Female, Male. Age: 18-64 years, 65+ years. Enrolment: 105.
Status: Ongoing, recruiting. Start date (EU): 2026-01-08. Decision date: 2025-09-15. Results received: No. Last updated: 2026-06-15.

Condition(s): Major Depression Disorder (MDD), Major Depression
Product: The placebo product is a size 1, opaque, orange hard gelatine capsule, identical in appearance and similar weight to the IMP. The placebo capsules will be filled with microcrystalline cellulose., D-Cycloserine 100 mg

Primary endpoint: Between-group difference in change of blinded rater MADRS total score from baseline to Day 28 (21-35) after first treatment day (interview by blinded external rater via video consultation documented on item level in eCRF).
Endpoint(s): Change in observer rated depressive symptoms (MADRS) to treatment day 12 and 180 and Clinical Global Impression (CGI) at day 12, 28, and 180, Response and remission rates at all time points on observer (MADRS) and self-rated depressive symptoms Quick Inventory of Depressive Symptomatology-Self Report (QIDS-SR), Survival time to initiation of new antidepressant treatment, hospitalization or death during the whole study period (until day 180), Change in score from baseline to Day 5, 12, 42, and 180 (end of study) self-rated depressive symptoms (QIDS-SR); Intensity in Suicidal Ideation from Columbia Suicide Severity Rating Scale (ISI-CSSR); anxiety symptoms, General Anxiety Disorder 7 (GAD-7); functioning, Sheehan Disability Scale (SDS); general health perception, EQ-5D-5L, Change in cognitive functioning (THINC-it); pre-attentive stimuli detection, Mismatch Negativity (MMN); frontal oxygenation (fNIRS); resting EEG measures including frequency spectra, microstates, and aperiodic activity.

Source: https://euclinicaltrials.eu/ctis-public/view/2025-521686-27-01